EU clinical trial 2023-506265-65-00: Phase 1/2 Study of Erdafitinib Intravesical Delivery System (TAR-210) in Participants with Non-Muscle-Invasive or Muscle-Invasive Bladder Cancer
Protocol code: 42756493BLC1003
Sponsor: Janssen - Cilag International (Pharmaceutical company). Phase: Human Pharmacology (Phase I)- First administration to humans. Countries: Germany (ongoing, recruitment ended), Spain (ongoing, recruitment ended).
Therapeutic area(s): Diseases [C] - Neoplasms [C04]
Gender: Female, Male. Age: 18-64 years, 65+ years. Enrolment: 43.
Status: Ongoing, recruitment ended. Start date (EU): 2022-04-07. Decision date: 2024-03-18. Results received: No. Last updated: 2026-03-02.
Decision dates by country: ES: 2024-03-18, DE: 2024-03-20

Condition(s): Localized Bladder Cancer

Source: https://euclinicaltrials.eu/ctis-public/view/2023-506265-65-00